EU clinical trial 2024-514266-39-00: A Phase 1/2 Study of the Selective Anaplastic Lymphoma Kinase (ALK) Inhibitor NVL-655 in Patients with Advanced NSCLC and Other Solid Tumors (ALKOVE-1)
Protocol code: NVL-655-01
Sponsor: Nuvalent Inc. (Pharmaceutical company). Phase: Phase I and Phase II (Integrated)- First administration to humans. Countries: Belgium (authorised, recruiting), Netherlands (ongoing, recruiting), France (ongoing, recruiting), Spain (ongoing, recruiting), Germany (ongoing, recruiting), Italy (ongoing, recruiting).
Therapeutic area(s): Diseases [C] - Neoplasms [C04]
Gender: Female, Male. Age: 0-17 years, 18-64 years, 65+ years. Enrolment: 385.
Start date (EU): 2022-11-03. Decision date: 2024-11-04. Results received: No. Last updated: 2026-06-30.
Decision dates by country: ES: 2024-11-13, IT: 2024-11-18, BE: 2024-11-04, NL: 2024-12-03, FR: 2024-11-14, DE: 2024-11-07

Condition(s): Advanced Non-Small Cell Lung Cancer (NSCLC) and Other Solid Tumors with ALK rearrangement or activating ALK mutation
Product: NVL-655, NVL-655

Primary endpoint: Phase 1 - Incidence and severity of TEAEs and changes in clinically relevant laboratory parameters, Phase 1 - RP2D and, if applicable, the MTD, Phase 2 - ORR according to RECIST 1.1
Endpoint(s): Phase 1 - PK parameters of NVL-655, Phase 1 - ORR according to RECIST 1.1 assessment, Phase 2 - DOR, Phase 2 - IC-ORR, Phase 2 - Incidence and severity of TEAEs and changes in clinically relevant laboratory parameters, Phase 2 - PK parameters of NVL-655, Phase 2 - Changes in PROs

Source: https://euclinicaltrials.eu/ctis-public/view/2024-514266-39-00